EU clinical trial 2024-517383-28-00: rFVIIa for Acute Hemorrhagic Stroke Administered at Earliest Time (FASTEST) Trial
Protocol code: U1111-1201-0087
Sponsor: University Of Cincinnati College Of Medicine (Educational Institution). Phase: Therapeutic confirmatory (Phase III). Countries: Germany (ongoing, recruiting), Spain (ongoing, recruiting).
Therapeutic area(s): Diseases [C] - Nervous System Diseases [C10]
Gender: Female, Male. Age: 18-64 years, 65+ years. Enrolment: 125.
Status: Ongoing, recruiting. Start date (EU): 2025-07-21. Decision date: 2024-09-24. Results received: No. Last updated: 2026-07-10.
Decision dates by country: ES: 2024-09-27, DE: 2024-09-24

Condition(s): Acute haemorrhagic stroke
Product: NovoSeven 5 mg (250 KIU) powder and solvent for solution for injection, Eptacog alfa Placebo

Primary endpoint: Part 1: The primary outcome measure is the following distribution of the ordinal mRS (modified Rankin Score) at 180 days: 0-2, 3, and 4-6. Part 2: The primary outcome measure is the following distribution of the ordinal mRS (modified Rankin Score) at 90 days: 0-2, 3, and 4-6.
Endpoint(s): Secondary Endpoints include the ordinal mRS (all seven steps)routine CT, utility-weighted Rankin Score, mRS of 0-2, and EQ-5D at 90 days and 180 days; the trichotomous endpoint at 180 days for Part 2;and change in the volume of ICH and ICH-IVH (intraventricular hemorrhage) between the baseline routine CT and 24- hour routine CT.

Source: https://euclinicaltrials.eu/ctis-public/view/2024-517383-28-00